EU clinical trial 2024-517713-33-00: A parallel-group treatment, phase 2a, double-blind, placebo-controlled 2-arm study to show improvement of physical function in SF-36 (SF-36-PF) in participants treated with Vericiguat compared to placebo tablets participants with post-COVID-19 syndrome without (PCS) or with (PCS/CFS) fulfillment of ME/CFS criteria - VERI-LONG
Protocol code: VERI-LONG
Sponsor: Charite Universitaetsmedizin Berlin KöR (Hospital/Clinic/Other health care facility). Phase: Therapeutic exploratory (Phase II). Countries: Germany (ended).
Therapeutic area(s): Diseases [C] - Virus Diseases [C02]
Gender: Female, Male. Age: 18-64 years. Enrolment: 104.
Status: Ended. Start date (EU): 2023-05-31. End date (EU): 2026-05-07. Decision date: 2024-11-13. Results received: No. Last updated: 2025-06-11.

Condition(s): Post-COVID-19 syndrome without (PCS) or with (PCS/CFS) fulfillment of myalgic encephalomyelitis/chronic fatique syndrome (ME/CFS) criteria
Product: PL1: placebo for Vericiguat, MK-1242, 2.5 mg and 5 mg; composition identical to the IMP, apart from the active substance, Vericiguat, Vericiguat, Vericiguat, PL2: placebo for Vericiguat, MK-1242, 10 mg; composition identical to the IMP, apart from the active substance

Primary endpoint: Primary outcome is to show intra-patient change in SF-36-PF from baseline to week 10
Endpoint(s): Occurrence of responders. Responders are defined as an intra-patient 10-point increase in SF-36-PF from baseline to week 10;, Intra-patient change in other SF-36 subdomains from baseline to week 10;, Intra-patient change in fatigue severity scale from baseline to week 10;, Intra-patient change in hand grip force (maximum, mean), fatigue ratio, and recovery rate from screening to week 10;, Occurrence of IMP side and adverse effects, assessed with AE, SAE and SUSAR reports.

Source: https://euclinicaltrials.eu/ctis-public/view/2024-517713-33-00